EU clinical trial 2023-503425-18-00: Dose Escalation and Dose Expansion Study of PD1-LAG3 Bispecific Antibody in Patients with Advanced and/or Metastatic Solid Tumors
Protocol code: NP41300
Sponsor: F. Hoffmann-La Roche AG (Pharmaceutical company). Phase: Human Pharmacology (Phase I)- First administration to humans. Countries: Spain (ongoing, recruitment ended), Denmark (ongoing, recruitment ended).
Therapeutic area(s): Diseases [C] - Neoplasms [C04]
Gender: Female, Male. Age: 18-64 years, 65+ years. Enrolment: 112.
Status: Ongoing, recruitment ended. Start date (EU): 2019-10-02. Decision date: 2023-07-27. Results received: No. Last updated: 2026-07-23.
Decision dates by country: DK: 2023-07-27, ES: 2023-07-31

Condition(s): Metastatic Solid Tumors

Source: https://euclinicaltrials.eu/ctis-public/view/2023-503425-18-00